EU clinical trial 2024-512641-16-00: “Efficacy and safety of 72-hour infusion of Prostacyclin (1 ng/kg/min) in mechanically ventilated patients with infectious pulmonary endotheliopathy – a multicentre randomized, placebo-controlled, blinded, investigator-initiated trial” (COMBAT-ARF).
Sponsor: Rigshospitalet (Hospital/Clinic/Other health care facility). Phase: Therapeutic exploratory (Phase II). Countries: Denmark (ongoing, recruiting).
Therapeutic area(s): Diseases [C] - Respiratory Tract Diseases [C08]
Gender: Female, Male. Age: 18-64 years, 65+ years. Enrolment: 450.
Status: Ongoing, recruiting. Start date (EU): 2024-04-15. Decision date: 2024-03-25. Results received: No. Last updated: 2026-01-26.

Condition(s): Infectious pulmonary endotheliopathy
Product: Natriumklorid ”B. Braun”, Ilomedin, koncentrat til infusionsvæske, opløsning

Primary endpoint: 28-day all cause mortality
Endpoint(s): 90-day mortality, Days alive without vasopressor in the ICU within 28-and 90 days, Days alive without mechanical ventilation in the ICU within 28 -and 90 days, Days without renal replacement in the ICU within 28-and 90 days, Numbers of serious adverse reactions within the first 7 days, Numbers of serious adverse events within the first 7 days

Source: https://euclinicaltrials.eu/ctis-public/view/2024-512641-16-00